EU clinical trial 2023-507445-28-00: A study to compare two different aramchol formulations in healthy volunteers.
Protocol code: CGA23001
Sponsor: CCDRD Cooperative Clinical Drug Research and Development AG, Galmed Research And Development Ltd. (Pharmaceutical company). Phase: Human Pharmacology (Phase I)- Other. Countries: Bulgaria (ended).
Therapeutic area(s): Diseases [C] - Digestive System Diseases [C06]
Gender: Female, Male. Age: 18-64 years. Enrolment: 16.
Status: Ended. Start date (EU): 2024-12-18. End date (EU): 2025-06-12. Decision date: 2024-12-13. Results received: No. Last updated: 2024-12-13.

Condition(s): Nonalcoholic fatty liver disease, Nonalcoholic steatohepatitis, Primary sclerosing cholangitis

Source: https://euclinicaltrials.eu/ctis-public/view/2023-507445-28-00